EU clinical trial 2024-519818-31-01: A Phase 3 Randomized, Open-label Study of Rinatabart Sesutecan (Rina-S) Versus Treatment of Investigator’s Choice (IC) in Patients With Endometrial Cancer After Platinum-Based Chemotherapy and PD(L)-1 Therapy
Protocol code: GCT1184-03
Sponsor: Genmab A/S (Pharmaceutical company). Phase: Therapeutic confirmatory (Phase III). Countries: Poland (ongoing, recruiting), Denmark (authorised, recruiting), Finland (authorised, recruiting), Lithuania (authorised, recruiting), France (ongoing, recruiting), Germany (ongoing, recruiting), Spain (ongoing, recruiting), Belgium (ongoing, recruiting), Greece (ongoing, recruiting), Norway (ongoing, recruiting), Italy (ongoing, recruiting).
Therapeutic area(s): Diseases [C] - Neoplasms [C04]
Gender: Female. Age: 18-64 years, 65+ years. Enrolment: 293.
Start date (EU): 2026-04-10. Decision date: 2026-03-26. Results received: No. Last updated: 2026-08-06.
Decision dates by country: PL: 2026-04-07, DK: 2026-03-27, BE: 2026-04-13, FI: 2026-04-02, LT: 2026-03-26, DE: 2026-03-27, FR: 2026-03-30, NO: 2026-04-16, IT: 2026-04-22, GR: 2026-03-30, ES: 2026-04-15

Condition(s): Endometrial Cancer Advanced, Recurrent, Metastatic, or Primary Unresectable Endometrial Cancer
Product: DOXORUBICIN, Rinatabart Sesutecan, PACLITAXEL

Primary endpoint: 1. Progression-free survival (PFS) per Response Criteria in Solid Tumors (RECIST) v1.1, as Determined by Blinded independent central review (BICR) [Time Frame: Up to approximately 3 years], 2. Overall Survival (OS) [Time Frame: Up to approximately 3 years]
Endpoint(s): Objective Response Rate (ORR), per RECIST v1.1, as Determined by BIRC, PFS, per RECIST v1.1, as determined by investigator assessment, ORR, per RECIST v1.1, as Determined by investigator assessment, Duration of Objective Response (DOR), per RECIST v1.1, as Determined by Investigator Assessment, DOR, per RECIST v1.1, as Determined by BICR, Number of Participants with Treatment-emergent Adverse Events (TEAEs), Change from Baseline in Global Health Status/Quality of Life (GHS/Qol), Time to Deterioration (TTD) in GHS/Qol

Source: https://euclinicaltrials.eu/ctis-public/view/2024-519818-31-01